EU clinical trial 2023-504007-91-00: A Phase 1, Open-Label, Single-Dose Study To Evaluate The Pharmacokinetics Of Mavodelpar In Subjects With Impaired Hepatic Function
Protocol code: REN001-108
Sponsor: Reneo Pharmaceuticals Inc. (Pharmaceutical company). Phase: Human Pharmacology (Phase I)- Other. Countries: Hungary (ended).
Therapeutic area(s): Not possible to specify
Gender: Female, Male. Age: 18-64 years, 65+ years. Enrolment: 32.
Status: Ended. Start date (EU): 2023-07-06. End date (EU): 2023-11-20. Decision date: 2023-07-04. Results received: Yes. Last updated: 2023-07-04.

Condition(s): Impaired Hepatic Function; The study will enroll as following: · Group 1 (N =10) – Normal hepatic function (healthy subjects), single dose · Group 2 (N=8) – Mild hepatic impairment (Child-Pugh A - a score of 5 to 6), single dose · Group 3 (N=8) – Moderate hepatic impairment (Child-Pugh B a score of 7 to 9), single dose · Group 4 (N=6) – Severe hepatic impairment (Child-Pugh C a score of 10 to 15), single dose Healthy volunteers with normal hepatic function.
Product: REN001

Primary endpoint: AUClast, AUCinf, and Cmax for mavodelpar.
Endpoint(s): Safety: AEs., Safety: Absolute values and changes from baseline in clinical laboratory parameters (serum chemistry, hematology, coagulation, and urinalysis)., Safety: Absolute values and changes from baseline in vital signs (systolic/diastolic blood pressure, pulse, oral body temperature and respiratory rate)., Safety: Absolute values and changes from baseline in 12-lead electrocardiograms (ECGs; QT interval, heart rate corrected QT interval using Fridericia’s formula [QTcF], HR, PR, RR, and QRS)., Pharmacokinetics: AUClast, AUCinf, and Cmax for mavodelpar metabolites., Exploratory: Fraction of unbound mavodelpar in plasma (fu) and, if applicable, PK parameters expressed in terms of unbound mavodelpar concentrations (e.g., AUCu, Cumax, and CLu/F).

Source: https://euclinicaltrials.eu/ctis-public/view/2023-504007-91-00